EU clinical trial 2022-502263-38-00: Infliximab for non-Crohn Anal Fistulas
Sponsor: Aarhus University Hospital (Hospital/Clinic/Other health care facility). Phase: Therapeutic exploratory (Phase II). Countries: Denmark (ongoing, recruiting).
Therapeutic area(s): Diseases [C] - Digestive System Diseases [C06]
Gender: Female, Male. Age: 18-64 years. Enrolment: 44.
Status: Ongoing, recruiting. Start date (EU): 2023-09-01. Decision date: 2023-02-09. Results received: No. Last updated: 2025-12-15.

Condition(s): Anal fistula
Product: AZATHIOPRINE, INFLIXIMAB, SALINE, 8 mm kalktablet indkapsuleret i gelatine, SALINE

Primary endpoint: Improvement in fistula disease after 15 months of treatment to a degree where it enables surgical closure of fistula
Endpoint(s): Drop in Perianal Disease Activity index > 2 after 6, 12 and 15 months of treatment, Improvement evaluated by MRI after 15 and 30 months of treatment or prior, Improvement of Quality of Life (CAF-QOL-score) after 6, 12, 15 and 30 months, Patients who fulfill primary endpoint and achieve fistula healing 3, 6 and 12 months after fistula closure, Time from treatment start to achieved primary endpoint, Changes in fistula classification and activity, Complications to the medical treatment

Source: https://euclinicaltrials.eu/ctis-public/view/2022-502263-38-00